EU clinical trial 2022-501882-29-00: A Phase 3, Open-label, Single-arm, Multicenter Study to Evaluate the Pharmacokinetics, Pharmacodynamics, Efficacy, Safety, and Immunogenicity of Ravulizumab Administered Intravenously in Pediatric Participants (6 to < 18 years of age) with Generalized Myasthenia Gravis (gMG)
Protocol code: ALXN1210-MG-319
Sponsor: Alexion Pharmaceuticals Inc. (Pharmaceutical company). Phase: Therapeutic confirmatory (Phase III). Countries: France (ended), Netherlands (ended), Spain (ended), Italy (ongoing, recruiting).
Therapeutic area(s): Diseases [C] - Nervous System Diseases [C10]
Gender: Female, Male. Age: 0-17 years, 18-64 years. Enrolment: 4.
Start date (EU): 2023-11-03. Decision date: 2023-06-21. Results received: No. Last updated: 2026-06-05.
Decision dates by country: ES: 2023-06-26, NL: 2023-06-21, FR: 2023-06-22, IT: 2023-06-22

Condition(s): Generalized Myasthenia Gravis (gMG)
Product: Ultomiris 300 mg/3 mL concentrate for solution for infusion

Primary endpoint: Summary statistics of ravulizumab concentrations at Day 1 predose through Week 18 predose, Summary statistics of serum free C5 at Day 1 predose through Week 18 predose
Endpoint(s): Efficacy and QoL: Change from baseline in QMG total score through Week 18, Change from baseline in MG-ADL total score through Week 18, Change from baseline in MGC score through Week 18, MGFA-PIS through Week 18, Change from baseline in Neuro-QoL Pediatric Fatigue score through Week 18 (participants ≥ 8 years of age only), Change from baseline in PROMIS Parent Proxy – Fatigue score through Week 18 (participants < 8 years of age only), Proportion of participants with ≥ 5-point reduction compared to baseline in the QMG total score over time through Week 18, Proportion of participants with ≥ 3-point reduction compared to baseline in the MG-ADL total score over time through Week 18, Proportion of participants that improve or remain stable in QMG total score at Week 18 compared to baseline (stable defined as ± 5-point change from baseline), Proportion of participants that improve or remain stable in MG-ADL total score at Week 18 compared to baseline (stable defined as ± 3-point change from baseline), Safety: Incidence of AEs and SAEs, Immunogenicity: ADA incidence, response categories, and titer, as well as NAb incidence, for the duration of the study., Long-term Extension: Estimands and endpoints described above will be evaluated through the end of the Extension Period

Source: https://euclinicaltrials.eu/ctis-public/view/2022-501882-29-00